EU clinical trial 2023-506594-35-00: [68Ga]Ga-FAPI-46 positron emission tomography for detection of lymph node metastasis in early rectal cancer (FARE Trial)
Sponsor: Amsterdam UMC (Hospital/Clinic/Other health care facility). Phase: Therapeutic use (Phase IV). Countries: Netherlands (ongoing, recruiting).
Therapeutic area(s): Diseases [C] - Digestive System Diseases [C06]; Analytical, Diagnostic and Therapeutic Techniques and Equipment [E] - Diagnosis [E01]
Gender: Female, Male. Age: 18-64 years, 65+ years. Enrolment: 50.
Status: Ongoing, recruiting. Start date (EU): 2025-03-24. Decision date: 2023-11-01. Results received: No. Last updated: 2025-12-10.

Condition(s): Rectal cancer
Product: GALLIUM (68GA) CHLORIDE

Primary endpoint: Group A: Diagnostic accuracy of [68Ga]Ga-FAPI-46 PET/CT for the detection of 1 or more LNM compared to final pathology after TME, defined as sensitivity and specificity., Group B: Rate of false-positive LNM on [68Ga]Ga-FAPI-46 PET/CT after local excision, defined as one or more suspected lymph nodes on [68Ga]Ga-FAPI-46 PET/CT that reveal no malignant cells on final histopathology after completion TME.
Endpoint(s): Per-lesion analysis of the diagnostic accuracy of [68Ga]Ga-FAPI-46 PET/CT for the detection of LNM compared to final pathology after TME., Percentage of agreement between tumor uptake in the lymph nodes on the [68Ga]Ga-FAPI-46 PET/CT scan, histopathologic evidence of tumor in the lymph nodes, and the expression of FAP on immunohistochemistry (IHC)., Percentage of potential change of therapy management enabled by [68Ga]Ga-FAPI-46 PET/CT., Difference in diagnostic accuracy for staging rectal cancer between different imaging modalities ([68Ga]Ga-FAPI-46 PET/CT versus regular CT and MRI., Diagnostic incidence of incidental findings, unrelated to the diagnosed rectal cancer, on [68Ga]Ga-FAPI-46 PET/CT., Diagnostic accuracy of incidental findings, unrelated to the diagnosed rectal cancer, on [68Ga]Ga-FAPI-46 PET/CT.

Source: https://euclinicaltrials.eu/ctis-public/view/2023-506594-35-00